EU clinical trial 2024-518228-63-01: Vascular changes in basal cell carcinoma undergoing electrochemotherapy or photodynamic therapy - assessed with optical coherence tomography
Sponsor: Region Sjaelland (Hospital/Clinic/Other health care facility). Phase: Therapeutic exploratory (Phase II). Countries: Denmark (ended).
Therapeutic area(s): Diseases [C] - Skin and Connective Tissue Diseases [C17]
Gender: Female, Male. Age: 18-64 years, 65+ years. Enrolment: 56.
Status: Ended. End date (EU): 2025-06-27. Decision date: 2024-11-25. Results received: No. Last updated: 2024-11-25.

Condition(s): basal cell carcinoma
Product: BLEOMYCIN

Primary endpoint: The primary objective is to investigate the microvascular changes in BCC during non-surgical treatment using D-OCT. The occlusion (diameter of the widest vessel at a given depth), reduction of the proportion of patent vessels at 0, 150, 300 and 500 micrometer depth will be assessed relative to pre-treatment and posttreatment levels according to visits.
Endpoint(s): To assess any predictors (thickness, density, attenuation and vascular pattern) in clinical outcome of of BCC undergoing non-surgical therapy by means of using D-OCT. To evaluate the quality of life in patients undergoing these treatments by SCQoL. To evaluate hyperpigmentation as a side effect of bleomycin

Source: https://euclinicaltrials.eu/ctis-public/view/2024-518228-63-01